EU clinical trial 2025-521605-40-00: Research into the effects of the drug DMT in healthy volunteers
Protocol code: CHDR2368
Sponsor: Centre for Human Drug Research (Laboratory/Research/Testing facility). Phase: Human Pharmacology (Phase I)- Other. Countries: Netherlands (temporarily halted).
Therapeutic area(s): Psychiatry and Psychology [F] - Mental Disorders [F03]
Gender: Female, Male. Age: 18-64 years. Enrolment: 12.
Status: Temporarily halted. Start date (EU): 2025-06-10. Decision date: 2025-06-06. Results received: No. Last updated: 2026-08-03.

Condition(s): major depressive disorder (MDD)

Source: https://euclinicaltrials.eu/ctis-public/view/2025-521605-40-00